EU clinical trial 2023-505721-13-00: STRIDER: A phase II Study evaluaTing intRacranial effIcacy of JDQ443 in patiEnts with KRAS G12C+ NSCLC and bRain metastases
Protocol code: CJDQ443B1NL01T
Sponsor: University Hospital Maastricht (Hospital/Clinic/Other health care facility). Phase: Therapeutic exploratory (Phase II). Countries: Netherlands (ended).
Therapeutic area(s): Diseases [C] - Respiratory Tract Diseases [C08]; Diseases [C] - Neoplasms [C04]
Gender: Female, Male. Age: 18-64 years, 65+ years. Enrolment: 42.
Status: Ended. End date (EU): 2024-06-10. Decision date: 2023-11-20. Results received: Yes. Last updated: 2023-11-20.

Condition(s): patients with KRAS G12C+ non small cell lung cancer and brain metastases
Product: JDQ443

Primary endpoint: Brain Metastases Objective Response Rate (RANO-BM criteria)
Endpoint(s): There are two secondary key endpoints: brain metastase disease control rate (RANO-BM) AND median CNS progression-free survival (RANO-BM)., Extracranial objective response rate (ORR) and disease control rate (DCR) (RECIST 1.1), Median extracranial progression-free survival (PFS) (based on RECIST 1.1), Median overall PFS (based on RANO-BM for BM and RECIST 1.1 for extracranial lesions), Median overall survival (OS), Quality of life (EORTC QLQ-BN20 and EORTC QLQ-C30), Safety (CTCAE v5.0)

Source: https://euclinicaltrials.eu/ctis-public/view/2023-505721-13-00